EU clinical trial 2023-504359-29-01: A randomized, double-blind, Phase 3 study comparing efficacy and safety of frexalimab (SAR441344) to placebo in adult participants with nonrelapsing secondary progressive multiple sclerosis
Protocol code: EFC17504
Sponsor: Sanofi-Aventis Recherche & Developpement (Pharmaceutical company). Phase: Therapeutic confirmatory (Phase III). Countries: Italy (ongoing, recruitment ended), Netherlands (ongoing, recruitment ended), Belgium (ongoing, recruitment ended), Bulgaria (ongoing, recruitment ended), Spain (ongoing, recruitment ended), Hungary (ongoing, recruitment ended), Portugal (ongoing, recruitment ended), Czechia (ongoing, recruitment ended), Germany (ongoing, recruitment ended), Poland (ongoing, recruitment ended), Sweden (ongoing, recruitment ended), Greece (ongoing, recruitment ended), France (ongoing, recruitment ended).
Therapeutic area(s): Diseases [C] - Nervous System Diseases [C10]
Gender: Female, Male. Age: 18-64 years. Enrolment: 591.
Status: Ongoing, recruitment ended. Start date (EU): 2024-12-11. Decision date: 2024-11-25. Results received: No. Last updated: 2026-08-09.
Decision dates by country: SE: 2024-12-20, BE: 2024-11-26, PT: 2024-11-26, GR: 2024-11-26, PL: 2024-12-02, NL: 2024-11-25, DE: 2024-11-27, BG: 2024-11-28, HU: 2024-11-28, CZ: 2024-11-27, ES: 2024-11-28, IT: 2024-11-27, FR: 2024-11-28

Condition(s): Multiple sclerosis
Product: Frexalimab, Matched placebo for product

Primary endpoint: Time to onset of composite confirmed disability progression (cCDP) confirmed over 6 months
Endpoint(s): Time to onset of composite cCDP confirmed over 3 months in the double-blind treatment period, Time to onset of CDP confirmed over 3-months or 6 months in the double-blind treatment period, Time to onset of confirmed disability improvement (CDI) in the double-blind treatment period, Number of new and/or enlarging T2 hyperintense lesions per scan as detected by MRI, Percent change in brain volume loss as detected by MRI scans at the end of double-blind treatment period compared to Month 6, Change in cognitive function at the end of double-blind treatment period compared to baseline as assessed by symbol digit modalities test (SDMT), Change from baseline in multiple sclerosis impact scale 29 version 2 (MSIS-29v2) questionnaire scores over time in the double-blind treatment period, Change from baseline in patient reported outcome measurement information system (PROMIS) Fatigue multiple sclerosis (MS)-8a over time in the double-blind treatment period, Annualized relapse rate during the double-blind treatment period assessed by protocol defined adjudicated relapses, Adverse events, SAEs, AEs leading to permanent study intervention discontinuation, AESIs, and PCSAs in laboratory tests, ECG, and vital signs during the study period, Antidrug antibody over time, Change from baseline in serum Ig levels over time, Change from baseline in plasma neurofilament light chain (NfL) levels over time in the double-blind treatment period, Frexalimab plasma concentration over time in the double-blind treatment period

Source: https://euclinicaltrials.eu/ctis-public/view/2023-504359-29-01